EU clinical trial 2026-525727-24-00: Prospective, multicentre, open-label, single arm trial on contraceptive efficacy, safety and tolerability of LPRI-CF113 (Drospirenone 4 mg + 2.8 mg) during 13 cycles.
Protocol code: CF113-304
Sponsor: Chemo Research S.L. (Pharmaceutical company). Phase: Therapeutic confirmatory (Phase III). Countries: Sweden (authorised, recruitment pending), Czechia (authorised, recruitment pending), Spain (authorised, recruitment pending), Hungary (authorised, recruitment pending), Poland (authorised, recruitment pending), Finland (authorised, recruitment pending), Romania (authorised, recruitment pending).
Therapeutic area(s): Not possible to specify
Gender: Female. Age: 0-17 years, 18-64 years. Enrolment: 1550.
Status: Authorised, recruitment pending. Decision date: 2026-07-23. Results received: No. Last updated: 2026-07-31.
Decision dates by country: CZ: 2026-07-23, SE: 2026-07-27, PL: 2026-07-27, FI: 2026-07-23, ES: 2026-07-28, RO: 2026-07-28, HU: 2026-07-28

Condition(s): No medical condition
Product: LPRI-CF113

Primary endpoint: Pearl Index in non-breastfeeding women aged ≤ 35 years (at the time of screening).
Endpoint(s): Pearl Index in all women aged ≤ 35 years (age at the time of screening), Pearl Index in all women aged (15-45 years), Pearl Index in all women aged > 35 years (age at the time of screening), Pearl Index for method failure in non-breastfeeding women aged ≤ 35 years (age at the time of screening), Pearl Index for method failure in all women aged ≤ 35 years (age at the time of screening), Pearl Index for method failures in all women aged (15-45 years), PI after correction for back-up contraception and sexual activity (evaluable cycles) in nonbreastfeeding women aged ≤ 35 years (age at the time of screening), PI after correction for back-up contraception and sexual activity (evaluable cycles) in all women aged ≤ 35 years (age at the time of screening), PI after correction for back-up contraception and sexual activity (evaluable cycles) in all women aged (15-45 years)., Pregnancy ratio by life table analysis for evaluable cycles, exposure cycles, and perfect cycles in non-breastfeeding women aged ≤ 35 years (age at the time of screening), Adverse Events (AEs), Adverse events of special interest (AESI), Severe Adverse events (SAEs), Clinical laboratory parameters (Haematology, biochemistry including oestradiol levels and urinalysis), Vital Signs, Physical examination, Gynaecological examination, Transvaginal ultrasound examination, Mastodynia/mastalgia/dysmenorrhea, Participants (n; %) with bleeding, spotting and bleeding + spotting in each, treatment day, cycle, reference period and overall., Participants (n; %) with absence of bleeding, spotting and bleeding + spotting in each, treatment day, cycle, reference period and overall., Participants (n; %) with prolonged bleeding per cycle, reference period and overall., Number of bleedings, spotting and bleeding + spotting days per medication cycle, reference period and overall, Number of bleeding, spotting and bleeding + spotting episodes per reference period., Duration of bleeding or spotting episodes by cycle, Participants (n; %) with bleeding, spotting and bleeding + spotting in each, treatment day, cycle, reference period and overall, per BMI category., Participants (n; %) with absence of bleeding, spotting and bleeding + spotting in each, treatment day, cycle, reference period and overall, per BMI category., Number of bleeding, spotting and bleeding + spotting days per medication cycle, reference period and overall, per BMI category., Number of bleeding, spotting and bleeding + spotting episodes per reference period per BMI category., IP acceptability, Quality of Life Enjoyment and Satisfaction Questionnaires-Short Form (Q-LES-Q-SF)

Source: https://euclinicaltrials.eu/ctis-public/view/2026-525727-24-00